EU clinical trial 2022-503010-23-01: Cluster and Registry trial Of the Working group of heart failure in Denmark. Are CarvedilOl and Metoprolol succinate comPArable treatments in heart failure patients with Reduced Ejection fraction.
Protocol code: English
Sponsor: Odense University Hospital (Hospital/Clinic/Other health care facility). Phase: Therapeutic use (Phase IV). Countries: Denmark (ongoing, recruiting).
Therapeutic area(s): Diseases [C] - Cardiovascular Diseases [C14]
Gender: Female, Male. Age: 18-64 years, 65+ years. Enrolment: 5600.
Status: Ongoing, recruiting. Start date (EU): 2024-03-20. Decision date: 2023-06-16. Results received: No. Last updated: 2023-06-16.

Condition(s): Heart Failure
Product: Metoprololsuccinat AL 190 mg Retardtabletten, Carvedilol Mylan 25 mg, filmomhulde tabletten

Primary endpoint: The primary endpoint will be a combined endpoint of all-cause mortality or first hospitalization for worsening heart failure.
Endpoint(s): 1) All-cause mortality. 2) A combined endpoint of all-cause mortality or first hospitalization for worsening heart failure according to heart rhythm (sinus rhythm or atrial fibrillation/flutter).

Source: https://euclinicaltrials.eu/ctis-public/view/2022-503010-23-01